EU clinical trial 2025-521308-23-00: DOSE-FINDING CLINICAL TRIAL TO EVALUATE OF INTESTINAL LACTASE ACTIVITY VIA ORAL GAXILOSE ADMINISTRATION IN HEALTHY ADULT VOLUNTEERS
Protocol code: VPH-GXL-2025-1
Sponsor: Venter Pharma S.L. (Pharmaceutical company). Phase: Human Pharmacology (Phase I)- Other. Countries: Spain (ended).
Therapeutic area(s): Diseases [C] - Digestive System Diseases [C06]
Gender: Female, Male. Age: 18-64 years, 65+ years. Enrolment: 24.
Status: Ended. Start date (EU): 2025-11-07. End date (EU): 2026-06-26. Decision date: 2025-07-22. Results received: No. Last updated: 2025-11-07.

Condition(s): Hypolactasia

Source: https://euclinicaltrials.eu/ctis-public/view/2025-521308-23-00